EU clinical trial 2024-515945-40-00: IFCT-2103 DIAL De-escalation Immunotherapy mAintenance duration trial for stage IV Lung cancer patients with disease control after chemo-immunotherapy induction A phase II-III randomized trial evaluating maintenance pembrolizumab (± pemetrexed) until progression versus observation (± pemetrexed) after 6 months of platinum-based doublet chemotherapy plus pembrolizumab induction treatment in patients with stage IV Non-Small Cell Lung Cancer (NSCLC)
Protocol code: IFCT-2103
Sponsor: Intergroupe Francophone De Cancerologie Thoracique (Patient organisation/association). Phase: Phase II and Phase III (Integrated). Countries: France (ongoing, recruiting).
Therapeutic area(s): Diseases [C] - Neoplasms [C04]
Gender: Female, Male. Age: 18-64 years, 65+ years. Enrolment: 1360.
Status: Ongoing, recruiting. Start date (EU): 2022-05-02. Decision date: 2024-10-25. Results received: No. Last updated: 2025-05-23.

Condition(s): Non small cell lung cancer
Product: PACLITAXEL, CISPLATIN, CARBOPLATIN, CISPLATIN, CARBOPLATIN, PACLITAXEL, PEMBROLIZUMAB, PEMETREXED, KEYTRUDA 25 mg/mL concentrate for solution for infusion, PEMETREXED

Primary endpoint: 18-month overall survival (OS) from inclusion in both arms, Overall Survival (OS) from randomization date
Endpoint(s): The time until definitive HRQol (Health Related Quality of Life) score deterioration, PFS from randomization at 6 months in both arms, OS according to the histological subtype squamous cell carcinoma vs. non-squamous, OS according to PD-L1 tumor level of expression in each arm, PFS from randomization at 6 months according to PD-L1 tumor level of expression in each arm

Source: https://euclinicaltrials.eu/ctis-public/view/2024-515945-40-00